EU clinical trial 2024-516011-24-01: Letermovir (LMV) prophylaxis in CMV-seronegative Allogeneic Stem Cell Transplant Recipients with CMV seropositive donors: an exploratory study from Spanish GETH/TC Centers
Sponsor: Grupo Espanol De Trasplante Hematopoyetico Y Terapia Celular (Patient organisation/association). Phase: Therapeutic exploratory (Phase II). Countries: Spain (ongoing, recruiting).
Therapeutic area(s): Diseases [C] - Virus Diseases [C02]
Gender: Female, Male. Age: 18-64 years, 65+ years. Enrolment: 80.
Status: Ongoing, recruiting. Start date (EU): 2024-11-13. Decision date: 2024-10-07. Results received: No. Last updated: 2026-06-01.
Decision dates by country: ES: 2024-12-12

Condition(s): Cytomegalovirus infection in allogeneic stem cell transplant recipients
Product: PREVYMIS 240 mg film-coated tablets

Primary endpoint: csCMV infection is considered in case the patient requires pharmacological treatment according to standard clinical practice.
Endpoint(s): csCMV infection is considered in case the patient requires pharmacological treatment according to standard clinical practice., Clinical characteristic, Neutrophile (>0,5x10e9/L) and platelets engraftment (>20 x10e9/L) by week 4 and week 14, Death by any cause and death not related with disease relapse or progression, Death by any cause non related to relapse by week 14 and day 180, Time to onset of all-cause failure of prophylaxis against CMV infection during the 14 weeks of study-drug administration period including patients who discontinued the study drug because of virologic failure or for any other reason (e.g., an adverse event, nonadherence, or consent withdrawal)., Duration of any CMV-antiviral treatment by day 180 post-SCT, Direct cost of CMV-antiviral treatment and hospital resource, Incidence of blips, clinical and analytic characteristics., Incidence of untreated CMV DNAemia, Adverse events according to the CTCAE, physical examination and regular laboratory tests. Only adverse events (AE) related to the treatment according to investigator, Incidence of aGVHD within 120 days after HCT and its onset and severity, Incidence of relapse within 180 days after HCT and its onset and severity, Incidence of CMV DNAemia requiring PET within 100-180 days after HCT, Incidence of non-CMV infections within 180 days after HCT and its onset and severity

Source: https://euclinicaltrials.eu/ctis-public/view/2024-516011-24-01